EU clinical trial 2024-515907-20-00: A randomised, double-blind, placebo-controlled, two-part study to evaluate the pharmacokinetics, safety and tolerability, and preliminary efficacy of two dose levels of golexanolone in subjects with primary biliary cholangitis, fatigue, and cognitive dysfunction.
Protocol code: UCAB-CT-05
Sponsor: Umecrine Cognition AB (Pharmaceutical company). Phase: Phase I and Phase II (Integrated)- Other. Countries: Hungary (ended), Spain (ongoing, recruitment ended), Italy (ongoing, recruitment ended), Germany (ended), Greece (ended).
Therapeutic area(s): Phenomena and Processes [G] - Digestive System and Oral Physiological Phenomena [G10]
Gender: Female, Male. Age: 18-64 years, 65+ years. Enrolment: 116.
Start date (EU): 2025-05-23. Decision date: 2024-10-18. Results received: No. Last updated: 2026-08-06.
Decision dates by country: HU: 2024-10-18, ES: 2024-11-05, GR: 2024-10-24, DE: 2024-10-24, IT: 2024-10-22

Condition(s): Primary biliary cholangitis (PBC)
Product: GR3027 10 mg, Golexanolone Placebo Capsules, oral capsules, soft

Primary endpoint: Part A: Frequency, intensity, and seriousness of adverse events (AEs), changes from baseline to Day 5 in laboratory parameters and clinical safety parameters., Part B: Frequency, intensity, and seriousness of AEs, changes from baseline to Day 28 in laboratory parameters and clinical safety parameters.
Endpoint(s): Part A: PK parameters: after the first dose; after the last dose and accumulation ratio between first and last dose., Part A: Metabolite profile in human plasma and urine (to be reported separately)., Part B : Change from baseline to Day 28 in the following HRQoL measures: − PBC-40 scores for each of the domains (cognition, itch, fatigue, social, emotional, and general symptoms). − EQ-5D-3L tool, Part B: Change from baseline to Day 28 in daytime sleepiness related symptoms using the Epworth Sleepiness Scale (ESS)., Part B: Change from baseline to Day 28 in a battery of cognitive tests, including: − Portosystemic Hepatic Encephalopathy Score (PHES) total score − Rey Auditory Verbal Learning test (RAVLT) − Delis and Kaplan Executive Function System (D-KEFS) Letter and Category fluency subtests, Part B: Clinical Global Impression of change, PBC version (CGI-C-PBC)., Part B: Lowest plasma concentration before the next dose (Ctrough) will be assessed pre-dose on Days 1, 7, 14 and 28.

Source: https://euclinicaltrials.eu/ctis-public/view/2024-515907-20-00